EU clinical trial 2025-522255-25-00: J5E-MC-JZXB - FRAmework-01: A Two-Part Phase 3 Study of Sofetabart Mipitecan (LY4170156) versus Chemotherapy or Mirvetuximab Soravtansine in Platinum-Resistant Ovarian Cancer, and Sofetabart Mipitecan plus Bevacizumab versus Platinum-Based Chemotherapy plus Bevacizumab in Platinum-Sensitive Ovarian Cancer
Protocol code: J5E-MC-JZXB
Sponsor: Eli Lilly & Co. (Pharmaceutical company). Phase: Therapeutic confirmatory (Phase III). Countries: Netherlands (ongoing, recruiting), Hungary (ongoing, recruiting), France (ongoing, recruiting), Austria (authorised, recruitment pending), Poland (ongoing, recruiting), Italy (ongoing, recruiting), Denmark (ongoing, recruiting), Romania (ongoing, recruiting), Greece (ongoing, recruiting), Norway (ongoing, recruiting), Czechia (ongoing, recruiting), Belgium (ongoing, recruiting), Spain (ongoing, recruiting), Ireland (authorised, recruitment pending), Germany (ongoing, recruiting).
Therapeutic area(s): Diseases [C] - Neoplasms [C04]
Gender: Female. Age: 18-64 years, 65+ years. Enrolment: 486.
Start date (EU): 2026-05-18. Decision date: 2026-05-11. Results received: No. Last updated: 2026-06-09.
Decision dates by country: HU: 2026-05-15, IE: 2026-05-15, IT: 2026-05-12, RO: 2026-05-18, ES: 2026-05-18, PL: 2026-05-15, AT: 2026-05-17, BE: 2026-05-12, CZ: 2026-05-12, DK: 2026-05-11, FR: 2026-05-13, DE: 2026-05-12, GR: 2026-05-11, NO: 2026-05-11, NL: 2026-05-11

Condition(s): Fallopian Tube Neoplasms, Neoplasm Metastasis, Ovarian Neoplasms, Peritoneal Neoplasms
Product: BEVACIZUMAB, CARBOPLATIN, TOPOTECAN, PACLITAXEL, GEMCITABINE, DOXORUBICIN, LY4170156, MIRVETUXIMAB SORAVTANSINE

Primary endpoint: • Part A: Progression-free Survival (PFS) per Response Evaluation Criteria in Solid Tumors (RECIST) v1.1 by Investigator • Part B: Progression-free Survival (PFS) per Response Evaluation Criteria in Solid Tumors (RECIST) v1.1 by blinded, independent, central review (BICR)

Source: https://euclinicaltrials.eu/ctis-public/view/2025-522255-25-00